EU clinical trial 2023-507672-52-00: SatisfACtion: A Phase I/II, open-label, multi-center study of [225Ac]Ac-PSMA-R2 in men with metastatic hormone sensitive prostate cancer (mHSPC) and in men with heavily pre-treated PSMA positive metastatic castration resistant prostate cancer (mCRPC) with or without prior 177Lu-labelled PSMA-targeted radioligand therapy
Protocol code: CAAA802A12101
Sponsor: Novartis Pharma AG (Pharmaceutical company). Phase: Phase I and Phase II (Integrated)- First administration to humans. Countries: France (ongoing, recruitment ended).
Therapeutic area(s): Diseases [C] - Neoplasms [C04]
Gender: Male. Age: 18-64 years, 65+ years. Enrolment: 32.
Status: Ongoing, recruitment ended. Start date (EU): 2023-11-07. Decision date: 2024-01-15. Results received: No. Last updated: 2026-02-11.

Condition(s): PSMA-positive metastatic hormone sensitive prostate cancer (mHSPC) and metastatic Castration-resistant Prostate Cancer (mCRPC) with or without prior 177Lu-PSMA radioligand therapy.
Product: ABIRATERONE, DEGARELIX, RELUGOLIX, APALUTAMIDE, ABIRATERONE, ENZALUTAMIDE, ENZALUTAMIDE, ENZALUTAMIDE, AAA802, AAA502, Locametz 25 micrograms kit for radiopharmaceutical preparation, DEGARELIX ACETATE, DAROLUTAMIDE

Primary endpoint: Primary endpoint for dose escalation: Incidence and severity of DLTs during the DLT observation period (first 42 days of treatment).Incidence and severity of AEs and SAEs including changes in laboratory values, ECGs and vital signs by group and frequency schedule (Q6W and Q4W).Primary endpoint for dose expansion: Overall Response Rate (ORR) per in soft tissue according to PCWG3 modified RECIST v1.1 in absence of bone progression (as per PCWG3), by central assessment and (PSA50) response rate., Primary endpoint for dose escalation: Tolerability: Frequency of dose interruptions, reductions, discontinuations, and dose intensity by group.
Endpoint(s): Secondary endpoint for dose escalation: Secondary endpoint for dose expansion : ● Safety: Incidence and severity of AEs and serious adverse events (SAEs) including changes in laboratory values, electrocardiograms (ECGs) and vital signs by group., Secondary endpoint for dose escalation: Secondary endpoint for dose expansion : ● Tolerability: Frequency of dose interruptions, reductions, and dose intensity, by group., Escalation:ORR,DCR,BOR,rPFS,OS,DoR per PCWG3 (investigator), Time to 1st SSE, responses measured by PSA (response rate, duration, time to 1st response, time to progression). Change from baseline in ALP/LDH. Expansion:DCR,BOR,DoR in soft tissue only according to PCWG3 absence of bone progression (central). rPFS per PCWG3 (central) and PFS (local), OS, Time to 1st SSE, responses measured by PSA (response rate, duration, time to 1st response, time to progression), change from baseline in ALP/LDH., Radioactivity measurements in blood during Cycle 1 and derived PK parameters (i.e., AUC, Cmax, CL, Tmax, Vz, T1/2) of 225Ac-PSMA-R2 at different measurement times (post-secular equilibrium)., Secondary endpoint for dose expansion: Secondary endpoint for dose expansion in pre-177Lu and post-177Lu-labelled PSMA-targeted RLTs:Change from baseline in HRQoL as assessed by XeQoL, EQ-5D-5L, FACT-P and BPI-SF. With the exception of XeQoL, the other HRQoL’s will be assessed in dose expansion only.

Source: https://euclinicaltrials.eu/ctis-public/view/2023-507672-52-00